EU clinical trial 2024-514103-33-00: IMPALA Protocol: Intrapleural Photodynamic Therapy by Video-Assisted Thoracoscopy Followed by Anti-PD-1 NIVOLUMAB in Patients With Malignant Pleural Mesothelioma - a Pilot Study -
Protocol code: 2019_41
Sponsor: Centre Hospitalier Universitaire De Lille (Hospital/Clinic/Other health care facility). Phase: Therapeutic exploratory (Phase II). Countries: France (authorised, recruiting).
Therapeutic area(s): Diseases [C] - Neoplasms [C04]
Gender: Female, Male. Age: 18-64 years, 65+ years. Enrolment: 20.
Status: Authorised, recruiting. Start date (EU): 2022-05-09. Decision date: 2024-09-20. Results received: No. Last updated: 2026-05-12.

Condition(s): malignant pleural mesothelioma
Product: Gliolan 30 mg/ml powder for oral solution., OPDIVO 10 mg/mL concentrate for solution for infusion.

Primary endpoint: The primary endpoint will be the proportion of patients having the full multimodal treatment (target: 70% minimum of total patients, i.e. 14 out of 20 patients) without inacceptable and unexpected toxicity (grade≥3) according National Cancer Institute (NCI) criteria, reviewed by an Independent Survey Committee.
Endpoint(s): objective response rate (ORR) according to modified RECIST 1.1 criteria for mesothelioma (Armato and Nowak, J Thorac Oncology 2018) for pleural lesions; RECIST 1.1 for all other targets, Kaplan Meier curve for overall survival (mOS), Kaplan Meier curve for progression free survival (mPFS), assessment of quality of life (QoL) of patients by dedicated EORTC QLQ C30 (or LCSS-30) questionnaire before and after treatment (in annex, evaluation of chest pain evaluation using visual scale., Ancillary/biomarkers studies: (a) on fresh pleural tumor biopsies (done during VATS and PDT procedure) compared with tumor tissue obtained at the time of MPM diagnosis ± at the time of progression (if available): by immunohistochemistry (BAP-1, PD-L1… expression), whole exome sequencing (WES) including tumor mutational burden (TMB) and search of tumor specific variants in ctDNA, immune cells populations, etc;, Ancillary/biomarkers studies: (b) blood (plasma) samples will be collected before PDT, during Nivolumab treatment and at the time of progression enabling a monitoring of ctDNA and of biomarkers reflecting the anti-tumor immune response ;, Ancillary/biomarkers studies: (c) pleural effusion samples (when accessible) will be collected on EDTA during VATS then through IPC in the same goal than (b).

Source: https://euclinicaltrials.eu/ctis-public/view/2024-514103-33-00